EU clinical trial 2024-519801-36-00: An open label, balanced, randomized, two-treatment, two-period, two-sequence, single-dose, crossover, bioequivalence study comparing Ruxolitinib Tablets, 20 mg, manufactured by Sun Pharmaceutical Industries Limited, India with JAKAVI (ruxolitinib) tablets 20 mg, (each Jakavi 20 mg tablet contains 26.40 mg of ruxolitinib phosphate equivalent to 20 mg of ruxolitinib). Imported by: Novartis Biociências SA Av. Prof. Vicente Rao, 90 - São Paulo - SP CNPJ: 56.994.502/0001-30. Manufactured by: Novartis Pharma Stein AG, Stein – Switzerland, in healthy adult, human subjects under fasting condition.
Protocol code: RUXOL-18-24
Sponsor: Sun Pharmaceutical Industries Limited (Pharmaceutical company). Phase: Human Pharmacology (Phase I)- Bioequivalence Study. Countries: Romania (ended).
Therapeutic area(s): Diseases [C] - Neoplasms [C04]
Gender: Female, Male. Age: 18-64 years. Enrolment: 40.
Status: Ended. Start date (EU): 2025-07-14. End date (EU): 2025-08-11. Decision date: 2025-06-23. Results received: No. Last updated: 2025-06-23.

Condition(s): Myelofibrosis, polycythemia vera, acute and chronic graft-versus-host-disease.

Source: https://euclinicaltrials.eu/ctis-public/view/2024-519801-36-00